EU clinical trial 2022-502264-20-00: A phase I, open-label, single dose, mass balance trial to investigate metabolism and pharmacokinetics of BI 1291583(C-14) administered as oral solution in healthy male subjects
Protocol code: 1397-0016
Sponsor: Boehringer Ingelheim International GmbH (Pharmaceutical company). Phase: Human Pharmacology (Phase I)- Other. Countries: Netherlands (ended).
Therapeutic area(s): Diseases [C] - Respiratory Tract Diseases [C08]
Gender: Male. Age: 18-64 years. Enrolment: 8.
Status: Ended. Start date (EU): 2023-04-26. End date (EU): 2023-07-05. Decision date: 2023-04-14. Results received: Yes. Last updated: 2023-05-16.

Condition(s): Healthy

Primary endpoint: feurine, 0-tz (fraction of [14C]-radioactivity excreted in urine expressed as percentage of the administered dose over the time interval from 0 to the last quantifiable time point), fefaeces, 0-tz (fraction of [14C]-radioactivity excreted in faeces expressed as percentage of the administered dose over the time interval from 0 to the last quantifiable time point)
Endpoint(s): Cmax (maximum measured concentration of the analyte), AUC0-tz (area under the concentration-time curve of the analyte over the time interval from 0 to the last quantifiable time point)

Source: https://euclinicaltrials.eu/ctis-public/view/2022-502264-20-00